EU clinical trial 2024-513419-28-00: A study to test how well different doses of BI 3810477 are tolerated by healthy men
Protocol code: 1530-0001
Sponsor: Boehringer Ingelheim International GmbH (Industry). Phase: Human Pharmacology (Phase I)- First administration to humans. Countries: Belgium (ended).
Therapeutic area(s): Diseases [C] - Respiratory Tract Diseases [C08]
Gender: Male. Age: 18-64 years. Enrolment: 80.
Status: Ended. Start date (EU): 2024-10-22. End date (EU): 2025-06-12. Decision date: 2024-10-14. Results received: No. Last updated: 2025-01-23.

Condition(s): Healthy volunteer trial

Source: https://euclinicaltrials.eu/ctis-public/view/2024-513419-28-00